EU clinical trial 2025-522293-37-00: A Phase 1, placebo-controlled, randomized, participant- and assessor-blind, single-center study to assess the safety and immunogenicity of 2 dose levels of Nipah measles vector (MV-NiV) vaccine administered subcutaneously either as a single dose or as 2 consecutive doses at 4-week interval, in healthy non-exposed volunteers, aged 18-40 years
Protocol code: MV-NIV-001
Sponsor: Teikyo University (Educational Institution). Phase: Human Pharmacology (Phase I)- First administration to humans. Countries: Belgium (ongoing, recruiting).
Therapeutic area(s): Diseases [C] - Virus Diseases [C02]
Gender: Female, Male. Age: 18-64 years. Enrolment: 60.
Status: Ongoing, recruiting. Start date (EU): 2026-05-15. Decision date: 2026-03-09. Results received: No. Last updated: 2026-04-16.

Condition(s): Nipah Virus

Source: https://euclinicaltrials.eu/ctis-public/view/2025-522293-37-00